EU clinical trial 2024-520356-24-00: An Open-label, Randomized, Multi-Center Study to Evaluate the Efficacy and Safety of Induction Treatment with Melphalan/HDS Followed by Consolidation Treatment with Trifluridine–tipiracil plus Bevacizumab Versus Trifluridine–tipiracil plus Bevacizumab Alone in Patients with Refractory Metastatic Colorectal Cancer with Liver Dominant Disease
Protocol code: PHP-CRC-201
Sponsor: Delcath Systems Inc. (Pharmaceutical company). Phase: Therapeutic exploratory (Phase II). Countries: Spain (ongoing, recruiting), Germany (ongoing, recruiting), Czechia (ongoing, recruiting), Italy (ongoing, recruiting), Netherlands (ongoing, recruiting).
Therapeutic area(s): Diseases [C] - Neoplasms [C04]
Gender: Female, Male. Age: 18-64 years, 65+ years. Enrolment: 35.
Status: Ongoing, recruiting. Start date (EU): 2025-12-01. Decision date: 2025-07-08. Results received: No. Last updated: 2026-07-21.
Decision dates by country: CZ: 2025-07-16, ES: 2025-07-16, DE: 2025-07-08, IT: 2025-10-29, NL: 2025-10-31

Condition(s): Refractory Metastatic Colorectal Cancer with Liver Dominant Disease, Refractory Metastatic Colorectal Cancer with Liver Dominant Disease
Product: Lonsurf 15 mg/6.14 mg film-coated tablets, Zirabev 25 mg/ml concentrate for solution for infusion., MELPHALAN HIKMA 50 mg/10ml, poudre et solvant pour solution injectable / pour perfusion, Zirabev 25 mg/ml concentrate for solution for infusion, Lonsurf 20 mg/8.19 mg film-coated tablets

Primary endpoint: hPFS (time from randomization to the first occurrence of hepatic disease progression or death due to any cause)
Endpoint(s): Progression free survival (PFS), Objective response rate (ORR) (complete response [CR] + partial response [PR]), Hepatic ORR (hORR), Duration of response (DOR), Hepatic DOR (hDOR), Disease control rate (DCR), Hepatic DCR (hDCR), Overall survival (OS)

Source: https://euclinicaltrials.eu/ctis-public/view/2024-520356-24-00